EU clinical trial 2025-524612-11-00: Effect of an adjunctive intervention on the tolerability of semaglutide in overweight adults without diabetes: a prospective, randomised, double-blind, single-centre, placebo-controlled clinical trial (SEMTOL)
Protocol code: SEMTOL 1.0
Sponsor: University Of Tartu (Educational Institution). Phase: Therapeutic use (Phase IV). Countries: Estonia (ongoing, recruiting).
Therapeutic area(s): Diseases [C] - Nutritional and Metabolic Diseases [C18]
Gender: Female, Male. Age: 18-64 years, 65+ years. Enrolment: 100.
Status: Ongoing, recruiting. Start date (EU): 2026-07-20. Decision date: 2026-05-21. Results received: No. Last updated: 2026-05-21.

Condition(s): Overweight and obesity
Product: Rice flour, SEMAGLUTIDE, GRANISETRON

Primary endpoint: Semaglutide treatment tolerability operationalised as the severity of nausea measured using the 0–10 numeric rating scale (NRS) during the first 96 hours after semaglutide administration.
Endpoint(s): The period mean of the daily well-being according to numerical rating scale compared between treatment groups., Patient self-reported usage of daily oral study medication., Change in body weight from the baseline, Change in appetite, Incidence and severity of other side effects (vomiting, constipation, diarrhoea, abdominal pain, dizziness, fatigue, headache)

Source: https://euclinicaltrials.eu/ctis-public/view/2025-524612-11-00